EU clinical trial 2022-501969-42-00: A phase III, multicenter, randomized, open-label trial to evaluate the safety and efficacy of systemic therapy with regorafenib and pembrolizumab, versus locoregional therapy with transarterial chemoembolization (TACE) or transarterial radioembolization (TARE), for the first-line treatment of intermediate-stage hepatocellular carcinoma with beyond up-to-7 criteria (REPLACE).
Protocol code: TRIO041
Sponsor: Translational Research In Oncology (Laboratory/Research/Testing facility). Phase: Therapeutic confirmatory (Phase III). Countries: Belgium (ended), Spain (ended), Italy (ended), France (ended), Germany (ended), Romania (ended).
Therapeutic area(s): Diseases [C] - Neoplasms [C04]
Gender: Female, Male. Age: 18-64 years, 65+ years. Enrolment: 259.
Status: Ended. Start date (EU): 2024-03-28. End date (EU): 2026-02-06. End date: 2026-02-26. Decision date: 2023-11-27. Results received: No. Last updated: 2025-04-07.
Decision dates by country: BE: 2023-11-27, DE: 2023-11-29, FR: 2023-12-04, IT: 2023-12-01, ES: 2023-11-29, RO: 2024-06-17

Condition(s): Intermediate-stage hepatocellular carcinoma with beyond up-to-7 criteria.
Product: KEYTRUDA 25 mg/mL concentrate for solution for infusion, BAY 734506

Primary endpoint: PFS, defined as the time (in months) from the date of randomization until the date of progressive disease (PD) or death due to any cause, whichever occurs first. PD will be assessed locally by the Investigator using mRECIST.
Endpoint(s): PFS: from randomization until PD or death, assessed locally by the Investigator/BICR per RECIST 1.1, and by BICR per mRECIST., OS: from randomization until the date of death., ORR: per RECIST v.1.1 and mRECIST, as per Investigator and BICR assessment., TTUP: from randomization until any protocol criteria are met related to liver function or HCC., DOR: per Investigator assessment or death, in patients who had a best OR of CR or PR., Safety: frequency and severity of AEs and laboratory abnormalities.

Source: https://euclinicaltrials.eu/ctis-public/view/2022-501969-42-00